EU clinical trial 2024-514459-14-00: A Phase 2 Study Evaluating the Efficacy, Safety, Tolerability, and Pharmacokinetics of AMG 193 in Subjects with Methylthioadenosine Phosphorylase (MTAP)-deleted Previously Treated Advanced Non-Small Cell Lung Cancer (NSCLC)
Protocol code: 20230153
Sponsor: Amgen Inc. (Pharmaceutical company). Phase: Therapeutic exploratory (Phase II). Countries: Portugal (ongoing, recruitment ended), Italy (ended), Hungary (ended), Belgium (ended), Spain (ended), Latvia (ended), Netherlands (ended), Czechia (ended), Poland (ended), Greece (ended), France (ended), Germany (ended).
Therapeutic area(s): Diseases [C] - Neoplasms [C04]
Gender: Female, Male. Age: 18-64 years, 65+ years. Enrolment: 107.
Start date (EU): 2025-04-22. Decision date: 2025-03-04. Results received: No. Last updated: 2026-07-08.
Decision dates by country: PL: 2025-03-06, BE: 2025-03-04, LV: 2025-03-06, IT: 2025-03-05, NL: 2025-03-07, ES: 2025-03-04, DE: 2025-03-05, GR: 2025-03-06, FR: 2025-03-06, CZ: 2025-03-04, HU: 2025-03-07, PT: 2025-03-07

Condition(s): Non-Small Cell Lung Cancer
Product: AMG 193

Primary endpoint: Objective response (OR) (complete response [CR] and partial response [PR]) measured by computed tomography (CT) or Magnetic resonance imaging (MRI) and assessed per Response Evaluation Criteria in Solid Tumors version 1.1 (RECIST 1.1), Incidence of treatment-emergent adverse events (TEAEs), grade ≥ 3 TEAEs, Serious Adverse Events (SAEs), and Events of Interest (EOIs), Pharmacokinetic (PK) parameters of AMG 193 including, but not limited to, maximum concentration (Cmax), time to maximum concentration (Tmax), and area under the concentration-time curve (AUC), OR (CR and PR) per RECIST 1.1
Endpoint(s): Disease control (DC), Duration of response (DOR), Time to response (TTR), Progression free survival (PFS), OR (CR and PR), DC, DOR, TTR, PFS, Overall survival (OS), Incidence and severity of TEAEs, grade ≥ 3 TEAEs, SAEs, and EOIs, PK parameters of AMG 193 including, but not limited to Cmax, Tmax, and AUC, Changes in cancer-specific symptoms, treatment-related symptom and overall health status using subject-reported outcome instruments: o EORTC QLQ-C30 o QLQ LC13 o EQ-5D-5L o PRO-CTCAE o GP5 of FACT-G

Source: https://euclinicaltrials.eu/ctis-public/view/2024-514459-14-00